EU clinical trial 2025-523119-12-00: Phase II-III study to assess the efficacy and safety of sublingual immunotherapy in patients suffering from house dust mite allergy. A prospective, international, randomized, double-blind, placebo-controlled, multicentre, phase II-III trial.
Protocol code: SL-3R2A
Sponsor: ROXALL Medizin GmbH (Pharmaceutical company). Phase: Phase II and Phase III (Integrated). Countries: Germany (ongoing, recruitment ended), Spain (ongoing, recruitment ended).
Therapeutic area(s): Diseases [C] - Immune System Diseases [C20]
Gender: Female, Male. Age: 18-64 years. Enrolment: 40.
Status: Ongoing, recruitment ended. Start date (EU): 2026-04-02. Decision date: 2026-01-13. Results received: No. Last updated: 2026-01-19.
Decision dates by country: DE: 2026-01-13, ES: 2026-01-19

Condition(s): Patients with moderate-to-severe allergic rhinitis / rhinoconjunctivitis due to house dust mites (HDM) for at least one year according to the Allergic Rhinitis and its Impact on Asthma (ARIA, Bousquet et al., 2008) guideline
Product: Placebo preparation identical to verum except that it does not include the active substance, i.e. allergen extract, SLI-RX-DPT mid dose, SLI-RX-DPT low dose, SLI-RX-DPT high dose

Primary endpoint: The primary (efficacy) endpoint is defined as the absolute differences in mean CSMS (Combined Symptom and Medication Score) during PEEP of each active treatment group compared with placebo treatment group.
Endpoint(s): Absolute and relative differences in mean dSS during PEEP, Absolute and relative differences in mean dMS during PEEP., Absolute and relative differences in the 4 mean nasal individual symptom scores during PEEP., Change in Global Rhinoconjunctivitis Discomfort with a 10.0-point Visual Analogue Scale (VAS) between active and placebo treatment groups comparing pre- (baseline) and post-treatment scaling., Change in Rhinoconjunctivitis quality of life questionnaire (RQLQ) between active and placebo treatment groups comparing pre- (baseline) and post-treatment scoring, Well and severe days: A well day is defined as a day without administration of any rescue medication (dMS = 0) and with dSS < 0.5 (range 0-3). A severe day is defined (acc. to Pfaar et al., 2014) as a day with a single score = 3 in any of the four symptoms. Percentages of well and severe days will be calculated for each subject as the number of well or severe days in the PEEP in relation to 56 days comprising the PEEP., Symptom-free days are defined as the days with absence of symptoms (dSS = 0) and without administration of any rescue medication (dMS = 0), expressed as percentage of days during the PEEP., titrated Nasal Provocation Test to assess the efficacy of each dose of SLI-RX-DPT compared to placebo. Defined as % of patients with an increased dosing step and the change in number of dosing steps needed to provoke a positive response in the tNPT post-treatment compared with pre-treatment in each of the 4 treatment groups. This is based on the change of the response to nasal provocation with incremental concentrations of an allergen extract of D. pteronyssinus from baseline to post-treatment., To analyse the safety and tolerability of each dose of SLI-RX-DPT compared to placebo by Treatment-Emergent Adverse Drug Reactions (TEADR) and patients affected with TEADRs in each group

Source: https://euclinicaltrials.eu/ctis-public/view/2025-523119-12-00